EU clinical trial 2024-515438-33-00: B7981027 - A PHASE 3 RANDOMIZED, DOUBLE-BLIND, PLACEBO-CONTROLLED STUDY TO INVESTIGATE THE EFFICACY AND SAFETY OF RITLECITINIB IN PEDIATRIC PARTICIPANTS 6 TO LESS THAN 12 YEARS OF AGE WITH SEVERE ALOPECIA AREATA
Protocol code: B7981027
Sponsor: Pfizer Inc. (Pharmaceutical company). Phase: Therapeutic confirmatory (Phase III). Countries: Spain (ongoing, recruitment ended), France (ongoing, recruitment ended), Czechia (ongoing, recruitment ended), Italy (ongoing, recruitment ended), Poland (ongoing, recruitment ended).
Therapeutic area(s): Diseases [C] - Immune System Diseases [C20]
Gender: Female, Male. Age: 0-17 years. Enrolment: 68.
Status: Ongoing, recruitment ended. Start date (EU): 2026-01-12. Decision date: 2025-10-14. Results received: No. Last updated: 2026-07-02.
Decision dates by country: CZ: 2025-11-19, FR: 2025-10-14, IT: 2025-10-14, ES: 2025-10-15, PL: 2025-10-17

Condition(s): Alopecia areata
Product: Ritlecitinib, Placebo to match ritlecitinib 30 mg, Ritlecitinib tosilate, Placebo to match ritlecitinib 50 mg

Primary endpoint: Response based on achieving an absolute SALT score ≤10 at Week 24.
Endpoint(s): PGI‑C response defined as a score of “moderately improved” or “greatly improved” at Week 24., • Change from baseline (CFB) in SALT score at all visits. • Response based on achieving absolute SALT score ≤10 at all visits (except for that included as the primary endpoint). • Response based on achieving absolute SALT score ≤20 at all visits (except for that included as the primary endpoint)., PGI-C response at all visits (except for that included as a key secondary endpoint)., •Response based on improvement from baseline for each AAPPO Item (11 endpoints). •CFB in AAPPO activity limitation and emotional symptoms scores at all visits. • CFB in PROMIS Parent Proxy Depressive Symptoms T-score at all visits., •CFB in PROMIS Parent Proxy Anxiety Symptoms T-score at all visits. •CFB in BRIEF®2 T-scores for the 3 index scores (Behavior Regulation Index [BRI], Emotional Regulation Index [ERI], Cognitive Regulation Index [CRI]) at all visits. •CFB in modified CDLQI total score at all visits., • Response based on achieving at least 2 grade improvement or a score of 3 in EBA score at all visits in participants with an abnormal EBA at baseline., Response based on achieving at least 2 grade improvement or a score of 3 in ELA score at all visits in participants with an abnormal ELA at baseline., Plasma concentration of ritlecitinib at 1 hr (±15 min) and 3 hr (±30 min) post-dose at Week 4 or Week 8., •Incidence of treatment-emergent adverse events (AEs) (including audiological and neurological treatment-emergent AEs). •Incidence of serious AEs (SAEs) and AEs leading to permanent discontinuation from the study., Acceptability and palatability assessment.

Source: https://euclinicaltrials.eu/ctis-public/view/2024-515438-33-00